EU clinical trial 2025-521699-71-01: Platelet function testing in outpatients after heart transplantation on aspirin therapy
Sponsor: Medical University Of Vienna (Educational Institution). Phase: Therapeutic use (Phase IV). Countries: Austria (authorised, recruitment pending).
Therapeutic area(s): Diseases [C] - Cardiovascular Diseases [C14]; Analytical, Diagnostic and Therapeutic Techniques and Equipment [E] - Anesthesia and Analgesia [E03]
Gender: Female, Male. Age: 18-64 years, 65+ years. Enrolment: 100.
Status: Authorised, recruitment pending. Decision date: 2026-05-25. Results received: No. Last updated: 2026-05-25.

Condition(s): Patients who have undergone heart transplantation.
Product: Thrombo ASS 100 mg-Filmtabletten

Primary endpoint: Prescence of Aspirin resistance (defined via Multiplate® ASPI test)
Endpoint(s): Innovance® PFA-200 System Analyzer, VerifyNow®, Age, sex, BMI, active smoker, diabetes mellitus, hypertension, periods of rejection, cardiovascular events/stroke since heart transplantation, C-reactive protein (CRP), neoplasia, ICU stay after heart transplantation, CMV infection, physical activity, HDL-Cholesterol, LDL-Cholesterol, cholesterol, triglyceride

Source: https://euclinicaltrials.eu/ctis-public/view/2025-521699-71-01